EU clinical trial 2023-506082-60-00: I8F-MC-GPIG - Tirzepatide Study of Renal Function in People with Overweight or Obesity and Chronic Kidney Disease with or without Type 2 Diabetes: Focus on Kidney Hypoxia in Relation to Fatty Kidney Disease using Multiparametric Magnetic Resonance Imaging (TREASURE-CKD)
Protocol code: I8F-MC-GPIG
Sponsor: Eli Lilly & Co. (Pharmaceutical company). Phase: Therapeutic exploratory (Phase II). Countries: Denmark (ended), Austria (ended), Netherlands (ended).
Therapeutic area(s): Phenomena and Processes [G] - Metabolism [G03]
Gender: Female, Male. Age: 18-64 years, 65+ years. Enrolment: 44.
Status: Ended. Start date (EU): 2023-02-28. End date (EU): 2026-07-07. End date: 2026-07-30. Decision date: 2024-01-02. Results received: No. Last updated: 2026-07-10.
Decision dates by country: DK: 2024-01-02, AT: 2024-01-02, NL: 2024-01-09

Condition(s): Obesity, Overweight, CKD, Chronic Kidney Disease, T2D, Type 2 Diabetes
Product: TIRZEPATIDE, TIRZEPATIDE, Placebo to match LY3298176, TIRZEPATIDE, TIRZEPATIDE, TIRZEPATIDE, TIRZEPATIDE, IOHEXOL

Primary endpoint: Percent Change from Baseline in Renal Sinus Fat Content (MRI)

Source: https://euclinicaltrials.eu/ctis-public/view/2023-506082-60-00